EU clinical trial 2023-508532-56-00: Low INR to Minimize bleeding with mechanical valves Trial (LIMIT)
Protocol code: 2019.06.26
Sponsor: Hamilton Health Sciences Corporation (Hospital/Clinic/Other health care facility). Phase: Therapeutic confirmatory (Phase III). Countries: Spain (ongoing, recruiting), Belgium (ongoing, recruiting), Denmark (ongoing, recruiting), Germany (ongoing, recruiting), Italy (ongoing, recruiting), Netherlands (ongoing, recruiting).
Therapeutic area(s): Diseases [C] - Cardiovascular Diseases [C14]
Gender: Female, Male. Age: 18-64 years, 65+ years. Enrolment: 975.
Status: Ongoing, recruiting. Start date (EU): 2021-10-19. Decision date: 2023-11-23. Results received: No. Last updated: 2026-01-09.
Decision dates by country: ES: 2023-11-23, NL: 2024-12-24, IT: 2024-10-18, DE: 2024-10-10, DK: 2024-10-07, BE: 2023-11-24

Condition(s): Treatment with a Vitamin K Antagonist due to having a mechanical bileaflet aortic valve replacement.
Product: WARFARIN, WARFARIN, WARFARIN, PHENPROCOUMON, WARFARIN, ACENOCOUMAROL, WARFARIN, PHENPROCOUMON, WARFARIN, ACENOCOUMAROL

Primary endpoint: Thrombosis/thromboembolism (composite of ischemic stroke, systemic thromboembolism, valve thrombosis) and major bleeding.
Endpoint(s): All-cause mortality (selected rather than cardiovascular mortality, as cause-specific mortality is often difficult to ascertain or define in complex cardiovascular patients in whom multi-end-organ dysfunction may accompany cardiovascular decline), All clinically important bleeding, Minor bleeding, All stroke, Ischemic stroke, Hemorrhagic stroke, Type 1, 2 or 3 myocardial infarction, Systemic thromboembolism, Valve thrombosis, Pulmonary embolism, Deep vein thrombosis, New renal replacement therapy, Time in therapeutic range, Proportion of patients with extreme INR values (>4)

Source: https://euclinicaltrials.eu/ctis-public/view/2023-508532-56-00